EU clinical trial 2024-511052-41-00: A randomized, double-blind, placebo-controlled clinical trial of once-daily inhaled molgramostim nebulizer solution in adult subjects with autoimmune pulmonary alveolar proteinosis (aPAP)
Protocol code: SAV00605
Sponsor: Savara ApS (Pharmaceutical company). Phase: Therapeutic confirmatory (Phase III). Countries: Romania (ended), Italy (ended), Spain (ended), Germany (ended), Poland (ended), Belgium (ended), Portugal (ended), Ireland (ended), France (ongoing, recruitment ended).
Therapeutic area(s): Diseases [C] - Respiratory Tract Diseases [C08]
Gender: Female, Male. Age: 18-64 years, 65+ years. Enrolment: 34.
Start date (EU): 2021-05-10. Decision date: 2024-10-29. Results received: No. Last updated: 2026-07-20.
Decision dates by country: DE: 2024-10-30, PT: 2024-11-04, IE: 2024-10-29, ES: 2024-11-05, IT: 2024-11-26, RO: 2024-11-06, PL: 2024-11-16, BE: 2024-10-29, FR: 2025-05-14

Condition(s): Autoimmune Pulmonary Alveolar Proteinosis
Product: Placebo nebulizer solution, Molgradex

Primary endpoint: Change in % predicted DLCO from baseline to Week 24
Endpoint(s): Change in % predicted DLCO from baseline to Week 48, Change in SGRQ Total from baseline to Week 24, Change in SGRQ Activity from baseline to Week 24, Change in EC (expressed as peak METs) from baseline to Week 24, Change in SGRQ Total from baseline to Week 48, Change in SGRQ Activity from baseline to Week 48, Change in EC (expressed as peak METs) from baseline to Week 48

Source: https://euclinicaltrials.eu/ctis-public/view/2024-511052-41-00